EU clinical trial 2024-512714-18-00: An open-label, multi-center, phase 1/2 study to assess safety, efficacy, and cellular kinetics of YTB323 in participants with Relapsing Multiple Sclerosis with breakthrough disease activity during previous treatment with a highly efficacious therapy
Protocol code: CYTB323N12101
Sponsor: Novartis Pharma AG (Pharmaceutical company). Phase: Phase I and Phase II (Integrated)- Other. Countries: France (authorised, recruitment pending), Germany (ongoing, recruiting), Italy (authorised, recruitment pending), Spain (ongoing, recruiting).
Therapeutic area(s): Diseases [C] - Nervous System Diseases [C10]
Gender: Female, Male. Age: 18-64 years. Enrolment: 15.
Start date (EU): 2025-11-11. Decision date: 2025-03-21. Results received: No. Last updated: 2026-06-26.
Decision dates by country: IT: 2025-03-26, FR: 2025-03-21, DE: 2025-03-24, ES: 2025-03-24

Condition(s): Relapsing Multiple Sclerosis
Product: FLUDARABINE PHOSPHATE, TOCILIZUMAB, CYCLOPHOSPHAMIDE, YTB323

Primary endpoint: Change in safety parameters including, but not limited to severity and frequency dose limiting toxicities (DLTs) of Adverse Events (AEs) and findings in vital signs, laboratory, ECG, neurological status, and safety MRIs of the brain and spinal cord
Endpoint(s): Clinical measures for relapses and disability (includes EDSS, XX, T25FW, 9HPT, SDMT, XX) and MRI changes in disease activity (including new and enlarging T2 lesions and Gd-enhancing T1 lesions), YTB323 transgene expression levels by qPCR over time in blood; cellular kinetics parameters (Cmax, AUC, Tmax, Clast, Tlast), Safety data from each dose level, Pre-existing and treatment-induced immunogenicity (humoral, anti-YTB323 antibody; and cellular, presence of CAR19 specific CD4 and CD8 T cells measuring interferon gamma production)

Source: https://euclinicaltrials.eu/ctis-public/view/2024-512714-18-00